EU clinical trial 2025-521175-31-00: A First-in-Human, Open-Label, Dose-Escalation Study to Evaluate the Safety and Tolerability of Gene Therapy with TTX-381 for the Ocular Manifestations Associated with Neuronal Ceroid Lipofuscinosis Type 2 (CLN2) Disease
Protocol code: TTX-381-1102
Sponsor: Tern Therapeutics LLC (Pharmaceutical company). Phase: Phase I and Phase II (Integrated)- First administration to humans. Countries: Germany (authorised, recruitment pending).
Therapeutic area(s): Diseases [C] - Nervous System Diseases [C10]
Gender: Female, Male. Age: 0-17 years. Enrolment: 5.
Status: Authorised, recruitment pending. Decision date: 2025-07-03. Results received: No. Last updated: 2026-07-17.

Condition(s): Ocular manifestations of Neuronal Ceroid Lipofuscinosis (CLN) Type 2

Primary endpoint: Ocular and overall AEs and SAEs through Day 360
Endpoint(s): Change from baseline in area of EZ loss as measured by SD-OCT at Day 180, Change from baseline in area of ellipsoid zone (EZ) loss as measured by SD-OCT at Day 360, Change from baseline in central subfield PR layer thickness as measured by SD-OCT at Day 180, Change from baseline in central subfield photoreceptor (PR) layer thickness as measured by SD-OCT at Day 360, Measurement of TTX-381 TPP1 in aqueous humor at Day 90, Measurement of TTX-381 TPP1 in aqueous humor at Day 360, TTX-381 detected by qPCR in urine and tears, Anti-AAV9 antibodies in serum, ATPA in serum and CSF

Source: https://euclinicaltrials.eu/ctis-public/view/2025-521175-31-00